EU clinical trial 2024-515672-12-00: TILD-24-01 : A Phase 3, Randomized, Double-Blind, Placebo Controlled, Multicenter Study to Evaluate the Efficacy and Safety of Subcutaneous Tildrakizumab in Subjects with Moderate to Severe Genital Psoriasis
Protocol code: TILD-24-01
Sponsor: Sun Pharmaceutical Industries Limited (Pharmaceutical company). Phase: Therapeutic confirmatory (Phase III). Countries: Hungary (ongoing, recruitment ended), Bulgaria (ongoing, recruitment ended), Poland (ongoing, recruitment ended).
Therapeutic area(s): Diseases [C] - Skin and Connective Tissue Diseases [C17]
Gender: Female, Male. Age: 18-64 years, 65+ years. Enrolment: 105.
Status: Ongoing, recruitment ended. Start date (EU): 2025-05-27. Decision date: 2025-05-07. Results received: No. Last updated: 2026-05-12.
Decision dates by country: HU: 2025-05-07, PL: 2025-05-12, BG: 2025-05-08

Condition(s): Moderate to Severe Genital Psoriasis
Product: Tildrakizumab Placebo Solution for Injection, TILDRAKIZUMAB

Primary endpoint: Tildrakizimab vs placebo at week 16: Proportion of subjects with a modified sPGA-G score of clear (0) or almost clear (1) with at least a 2-point reduction from baseline
Endpoint(s): Proportion of subjects, with a baseline score of ≥4, who achieve at-least 4-point improvement in weekly average of GPI- NRS, Mean change from baseline in the affected BSA, Change from baseline in GPSS total score and individual items scores, Proportion of subjects with PASI 75 response (≥ 75% reduction from baseline in PASI score), Proportion of subjects with PASI 90 response (≥ 90% reduction from baseline in PASI score), Proportion of subjects with PASI 100 response (100% reduction from baseline in PASI score), insubjects with BSA <10%

Source: https://euclinicaltrials.eu/ctis-public/view/2024-515672-12-00